EU clinical trial 2023-503632-41-01: BEFAST STUDY: [68Ga]Ga-FAPI total body PET/CT for Better and Faster imaging in cancer Protocol: [68Ga]Ga-FAPI total body PET/CT for improving diagnostic sensitivity and preoperative staging in gastroesophageal cancer and pancreatic cancer
Sponsor: Rigshospitalet (Hospital/Clinic/Other health care facility). Phase: Therapeutic exploratory (Phase II). Countries: Denmark (ongoing, recruitment ended).
Therapeutic area(s): Analytical, Diagnostic and Therapeutic Techniques and Equipment [E] - Diagnosis [E01]; Diseases [C] - Neoplasms [C04]
Gender: Female, Male. Age: 18-64 years, 65+ years. Enrolment: 60.
Status: Ongoing, recruitment ended. Start date (EU): 2024-01-30. Decision date: 2023-11-01. Results received: No. Last updated: 2026-06-04.

Condition(s): Pancreatic cancer and gastroesophageal cancer (esophagus, gastroesophageal junction (GEJ) and gastric cancer)
Product: 68GA-FAPI-46, Visipaque, injektionsvæske, opløsning

Primary endpoint: 1) Sensitivity of lesions suspicious of malignancy of [68Ga]Ga-FAPI-46 TB PET/CT within 30 min of injection of the tracer compared with the sensitivity of current standard imaging modalities ([18F]FDG PET/CT, CT, MRI).
Endpoint(s): 1) Sensitivity of lesions suspicious of malignancy of [68Ga]Ga-FAPI-46 TB PET/CT after 60 min, as well as accuracy, specificity, positive predictive value (PPV) and negative predictive value (NPV), 2) Estimated potential impact/change in patient management., 3) Description of FAPI-uptake from lesions suspicious of malignancy.

Source: https://euclinicaltrials.eu/ctis-public/view/2023-503632-41-01